EU clinical trial 2024-518135-10-00: A randomized, placebo controlled, double blind, double dummy, multicenter trial comparing electronic cigarettes with nicotine to varenicline and to electronic cigarettes without nicotine. ECSMOKE
Protocol code: P150952J
Sponsor: Assistance Publique Hopitaux De Paris (Hospital/Clinic/Other health care facility). Phase: Therapeutic confirmatory (Phase III). Countries: France (temporarily halted).
Therapeutic area(s): Psychiatry and Psychology [F] - Behavior and Behavior Mechanisms [F01]
Gender: Female, Male. Age: 18-64 years, 65+ years. Enrolment: 650.
Status: Temporarily halted. Start date (EU): 2024-10-31. Decision date: 2024-10-31. Results received: No. Last updated: 2024-10-31.

Condition(s): Smokers smoking at least 10 cigarettes/day in the past year
Product: CHAMPIX 0.5 mg film-coated tablets, Placebo CHAMPIX ® 0.5mg Comprimé pelliculé

Primary endpoint: Continuous smoking abstinence rate during the last 4 weeks of a treatment period of 3 months.
Endpoint(s): The assessment criterion of the safety will be the comparison of serious adverse events and non-serious adverse events, Point prevalence abstinence: self-report of 7-day smoking abstinence at each visit associated with expired air CO ≤ 8 ppm., Time to relapse to smoking after the predefined target quit day, Change in cigarettes/day consumption, Change in craving for tobacco, Change in withdrawal symptoms

Source: https://euclinicaltrials.eu/ctis-public/view/2024-518135-10-00